EU clinical trial 2024-511319-91-00: (22615 SOHO-02) A Phase 3 open-label, randomized, active-controlled, multicenter trial to evaluate the efficacy and safety of orally administered BAY 2927088 compared with standard of care as a first-line therapy in patients with locally advanced or metastatic non-small cell lung cancer (NSCLC) with HER2-activating mutations
Protocol code: 22615
Sponsor: Bayer AG (Pharmaceutical company). Phase: Therapeutic confirmatory (Phase III). Countries: Italy (ongoing, recruitment ended), Spain (ongoing, recruitment ended), France (ongoing, recruitment ended), Denmark (ongoing, recruitment ended), Greece (ongoing, recruitment ended), Finland (ended), Portugal (ongoing, recruiting), Czechia (ongoing, recruitment ended), Sweden (ongoing, recruitment ended), Austria (ongoing, recruitment ended), Belgium (ongoing, recruitment ended), Germany (ongoing, recruitment ended), Bulgaria (ongoing, recruitment ended), Netherlands (ongoing, recruitment ended), Poland (ongoing, recruitment ended), Slovakia (ongoing, recruitment ended), Hungary (ended), Romania (ongoing, recruitment ended).
Therapeutic area(s): Diseases [C] - Neoplasms [C04]
Gender: Female, Male. Age: 18-64 years, 65+ years. Enrolment: 174.
Start date (EU): 2024-10-23. Decision date: 2024-09-30. Results received: No. Last updated: 2026-08-08.
Decision dates by country: SK: 2024-10-04, PL: 2024-10-07, AT: 2024-10-07, FI: 2024-10-01, NL: 2024-10-07, PT: 2024-10-02, RO: 2024-10-07, BE: 2024-10-07, BG: 2024-10-03, CZ: 2024-10-02, DK: 2024-09-30, FR: 2024-09-30, DE: 2024-10-04, GR: 2024-10-01, HU: 2024-10-04, IT: 2024-10-01, ES: 2024-10-01, SE: 2024-10-04

Condition(s): Advanced non-small cell lung cancer with HER2 (ERBB2) mutation
Product: Pemetrexed Fresenius Kabi 25 mg/ml concentrate for solution for infusion, BAY 2927088 Bayer (CM), KEYTRUDA 25 mg/mL concentrate for solution for infusion, BAY 2927088 Bayer, Carboplatin Kabi 10 mg/ml Konzentrat zur Herstellung einer Infusionslösung, Cisplatin Hikma 1 mg/ml Konzentrat zur Herstellung einer Infusionslösung, BAY 2927088 Bayer (CM), BAY 2927088

Primary endpoint: Progression free survival (PFS) per RECIST 1.1 as assessed by blinded independent central review (BICR)
Endpoint(s): Overall survival (OS), Objective response rate (ORR) per RECIST 1.1 as assessed by BICR, PFS per RECIST 1.1 as assessed by the investigator, ORR per RECIST 1.1 as assessed by the investigator, Disease control rate (DCR) per RECIST 1.1 as assessed by BICR, DCR per RECIST 1.1 as assessed by the investigator, Duration of response (DOR) as assessed by BICR, DOR as assessed by the investigator, Adverse events per CTCAE v 5.0 (eg. TEAEs, TESAEs) categorized by severity, Change from baseline in Non-small cell lung cancer Symptom Assessment Questionnaire (NSCLC-SAQ) total score, Change from baseline in NSCLC-SAQ individual domain scores (cough, pain, dyspnea, fatigue, appetite), Time to deterioration in NSCLC-SAQ total score, Time to deterioration in NSCLC-SAQ individual domain scores (cough, pain, dyspnea, fatigue, appetite), Time to deterioration in EORTC QLQ-C30 physical functioning domain score, Change from baseline in EORTC QLQ-C30 physical functioning domain score, Change from baseine in EORTC QLQ-C30 global health status/QoL

Source: https://euclinicaltrials.eu/ctis-public/view/2024-511319-91-00